EU clinical trial 2024-510614-33-00: 5-Aminolevulinic Acid (5-ALA) for Intraoperative Imaging in Patients with Ovarian Cancer – a Single Center Feasibility Study (ILLUMINATE)
Protocol code: GYN-202301
Sponsor: Rheinische Friedrich-Wilhelms-Universitaet Bonn (Educational Institution). Phase: Therapeutic exploratory (Phase II). Countries: Germany (ongoing, recruiting).
Therapeutic area(s): Analytical,Diagnostic,Therapeutic Techniques and Equipment [E]-Surgical Procedures, Operative [E04]; Diseases [C] - Female Urogenital Diseases and Pregnancy Complications [C13]
Gender: Female. Age: 18-64 years, 65+ years. Enrolment: 30.
Status: Ongoing, recruiting. Start date (EU): 2025-06-10. Decision date: 2024-09-10. Results received: No. Last updated: 2026-05-11.

Condition(s): Ovarian Cancer
Product: Gliolan 30 mg/ml powder for oral solution.

Primary endpoint: Percentage of patients with at least one 5-ALA positive and histologically positive ovarian cancer tumour manifestation that was not scheduled for resection based on the surgical plan established under standard conditions (normal light and palpation).
Endpoint(s): Assessment of active-substance-specific adverse reactions and serious adverse reactions of CTCAE grades 3, 4, and 5, Perioperative morbidity (30 days); Comparison with historical data on perioperative morbidity at the study site applying the Memorial Sloan Kettering Cancer Center (MSKCC) Surgical Secondary Events (SSE) system, Proportion of 5-ALA positive and histologically positive lesions out of all 5-ALA positive lesions, Proportion of 5-ALA positive and histologically positive lesions out of all histologically positive lesions, Proportion of patients in whom all 5-ALA positive lesions are histologically negative, Proportion of 5-ALA positive but histologically negative lesions among all 5-ALA positive lesions only, PCI change by considering additionally resected 5-ALA positive and histologically confirmed ovarian cancer tumour manifestations, Change of FIGO classification considering additionally resected 5-ALA positive and histologically confirmed ovarian cancer tumour manifestations

Source: https://euclinicaltrials.eu/ctis-public/view/2024-510614-33-00